EU clinical trial 2024-519402-12-00: Efficacy of non operative treatment with amoxicillin/clavulanic acid versus surgical treatment in acute uncomplicated appendicitis in children: a prospective multicenter randomized controlled non-inferiority trial with cost utility analysis
Sponsor: Centre Hospitalier Universitaire De Toulouse (Hospital/Clinic/Other health care facility). Phase: Therapeutic confirmatory (Phase III). Countries: France (authorised, recruitment pending).
Therapeutic area(s): Diseases [C] - Digestive System Diseases [C06]
Gender: Female, Male. Age: 0-17 years. Enrolment: 724.
Status: Authorised, recruitment pending. Decision date: 2025-10-17. Results received: No. Last updated: 2025-10-17.

Condition(s): uncomplicated appendicitis
Product: AMOXICILLINE/ACIDE CLAVULANIQUE PANPHARMA 500 mg/50 mg nourrissons et enfants, poudre pour solution injectable (I.V.), CEFOXITIN, AUGMENTIN 100 mg/12,50 mg par ml ENFANTS, poudre pour suspension buvable en flacon (rapport amoxicilline/acide clavulanique : 8/1), AUGMENTIN 500 mg/62,5 mg, comprimé pelliculé (rapport amoxicilline/acide clavulanique : 8/1), Levmentin 2000 mg/200 mg poudre pour solution pour perfusion

Primary endpoint: percentage of treatment-related failures at one year defined as : - secondary surgery, - In surgery group, a normal appendix based on pathology or a complication requiring a new general anaesthesia - Readmissions for suspected appendicitis, emergency room visits related to appendicitis treatment, postoperative infections, adverse effects of antibiotics, adverse effects of anesthesia
Endpoint(s): Differential cost-utility ratio between the two groups of treatment at one year, Direct Medical costs, and indirect costs (parental absenteeism) descriptions at 1 year, Using consumption data available in SNDS database, describe child care pathways over 5 years : Rehospitalization, appendectomy, Incidence of adverse events at day 30 and at one year in the two groups, and incidence of adverse events due to antibiotics in the NOT group

Source: https://euclinicaltrials.eu/ctis-public/view/2024-519402-12-00